EU clinical trial 2022-500863-10-00: A two part, randomized, participant and investigator-blinded, 2-arm, parallel-design, placebo-controlled study to evaluate the safety, tolerability and preliminary efficacy of NGI226 microparticles on tendon regeneration in patients with Achilles tendinopathy
Protocol code: CNGI226A12201
Sponsor: Novartis Pharma AG (Pharmaceutical company). Phase: Therapeutic exploratory (Phase II). Countries: Netherlands (expired), Germany (ended), France (ended).
Therapeutic area(s): Diseases [C] - Musculoskeletal Diseases [C05]
Gender: Female, Male. Age: 18-64 years, 65+ years. Enrolment: 26.
Status: Ended. Start date (EU): 2023-10-18. End date (EU): 2026-02-03. End date: 2026-02-04. Decision date: 2022-12-06. Results received: No. Last updated: 2025-06-30.
Decision dates by country: NL: 2022-12-12, DE: 2022-12-09, FR: 2022-12-06

Condition(s): Achilles Tendinopathy
Product: NGI226, Placebo to NGI226 100 mg Powder for suspension for injection

Primary endpoint: Part A and Part B: • Local and systemic treatment Emergent Adverse Events (TEAEs) and serious TEAEs • Local tolerability (changes in pain, swelling, redness, warmth, range of motion and itching, infection, tendon physical examination) • Laboratory tests (clinical chemistry, hematology, coagulation, Liver Function Test (LFT), urinalysis) • Electrocardiogram parameters (ECGs) • Vital signs (blood pressure, pulse rate, body, temperature)
Endpoint(s): Part A and Part B: Changes in tendon stiffness from baseline at week 12 assessed by ultrasound (US)-based shear wave elastography (SWE)

Source: https://euclinicaltrials.eu/ctis-public/view/2022-500863-10-00